EU clinical trial 2026-526294-42-00: An unblinded, single arm, pilot observational study to test the safety, tolerability, immunogenicity and the biological effects of TRB-001 vaccination in individuals who have previously undergone aSyn immunotherapy
Protocol code: TRB-Boost-001
Sponsor: Tridem Bioscience FlexCo (Pharmaceutical company). Phase: Human Pharmacology (Phase I)- Other. Countries: Austria (authorised, recruitment pending).
Therapeutic area(s): Diseases [C] - Nervous System Diseases [C10]
Gender: Female, Male. Age: 18-64 years, 65+ years. Enrolment: 8.
Status: Authorised, recruitment pending. Decision date: 2026-07-22. Results received: No. Last updated: 2026-07-22.

Condition(s): Parkinson's disease

Source: https://euclinicaltrials.eu/ctis-public/view/2026-526294-42-00